EU clinical trial 2025-524264-38-00: Phase IV, randomized, open label, parallel groups clinical trial for evaluating the early Stop of antibiotic Treatment in high-risk febrile neutropenic Oncohaematological Paediatric patients (e-STOP 2)
Protocol code: AB.OH.2025
Sponsor: Fundacio Hospital Universitari Vall D’Hebron Institut De Recerca (Laboratory/Research/Testing facility). Phase: Therapeutic use (Phase IV). Countries: Spain (ongoing, recruiting).
Therapeutic area(s): Not possible to specify
Gender: Female, Male. Age: 0-17 years, 18-64 years. Enrolment: 136.
Status: Ongoing, recruiting. Start date (EU): 2026-06-02. Decision date: 2026-05-05. Results received: No. Last updated: 2026-05-05.

Condition(s): Infectious diseases
Product: CEFEPIME, TEICOPLANIN, METRONIDAZOLE, METRONIDAZOLE, MEROPENEM, TAZOBACTAM, VANCOMYCIN, LEVOFLOXACIN, CIPROFLOXACIN, CEFTAZIDIME, METRONIDAZOLE, CIPROFLOXACIN, LEVOFLOXACIN, AMIKACIN, CIPROFLOXACIN, PIPERACILLIN

Primary endpoint: To evaluate the safety of discontinuing antibiotics by comparing the proportion of febrile neutropenia episodes with uncomplicated resolution at 28 days between the experimental group and the control group.
Endpoint(s): Days with fever., Days and type of antimicrobials administered., Days of neutropenia., Patient characteristics: age, sex, underlying disease, treatment phase, days since last chemotherapy cycle, type of catheter, clinical characteristics, physical examination, hours of fever on admission, vital signs, admission to paediatric ICU, risk stratification, Laboratory values (at the start of the FN episode, at 48-72 hours, at 5 days - if applicable - and at 28 days): complete blood count, serum biochemistry (see Appendix II), CRP, PCT., IL-8 (at the onset of NF and at 48-72 hours), Microbiological results: blood cultures and urine cultures and others if performed (nasopharyngeal swab, cerebrospinal fluid culture, etc.)., Results of B-HCG in urine., Imaging test results: X-ray, CT, MRI, ultrasound, among others., Incidence and severity of adverse events, Concomitant medication

Source: https://euclinicaltrials.eu/ctis-public/view/2025-524264-38-00